EU clinical trial 2024-517045-14-00: Phase I/II study of weekly infusions of JR-441 in patients with mucopolysaccharidosis type IIIA
Protocol code: JR-441-101
Sponsor: Jcr Pharmaceuticals Co. Ltd. (Pharmaceutical company). Phase: Human Pharmacology (Phase I)- First administration to humans. Countries: Germany (ongoing, recruitment ended).
Therapeutic area(s): Diseases [C] - Congenital, Hereditary, and Neonatal Diseases and Abnormalities [C16]
Gender: Female, Male. Age: 0-17 years. Enrolment: 15.
Status: Ongoing, recruitment ended. Start date (EU): 2023-09-26. Decision date: 2024-09-13. Results received: No. Last updated: 2026-03-16.

Condition(s): Mucopolysaccharidosis type IIIA (MPS IIIA)
Product: JR-441

Primary endpoint: 1. Occurrence of adverse events (AEs), 2. Changes in safety laboratory tests (hematology, coagulation, blood biochemistry, iron-related tests, and urinalysis), 3. Changes in vital signs (pulse rate, body temperature, blood pressure, respiratory rate, and percutaneous oxygen saturation), 4. Changes in 12-lead electrocardiogram (ECG), 5. Number and severity of infusion-associated reactions (IARs), occurrence of anaphylaxis
Endpoint(s): 1. Plasma drug concentration, 2. Plasma PK parameters, 3. Changes in the following parameters from baseline to each evaluation time point: (1) Heparan sulfate (HS concentration in CSF and serum, and HS concentration relative to creatinine concentration in urine. (2) Cognitive function assessed by Cognitive scales and/or Nonverbal Index (NVI); (3) Adaptive behavior assessment

Source: https://euclinicaltrials.eu/ctis-public/view/2024-517045-14-00